EU clinical trial 2024-518544-21-00: A Randomised controlled trial to compare efficacy and tolerability of Plenvu® and Picoprep® as cleansing agents before colonoscopy
Sponsor: Aalborg University Hospital (Hospital/Clinic/Other health care facility). Phase: Therapeutic use (Phase IV). Countries: Denmark (ongoing, recruiting).
Therapeutic area(s): Diseases [C] - Digestive System Diseases [C06]
Gender: Female, Male. Age: 18-64 years, 65+ years. Enrolment: 400.
Status: Ongoing, recruiting. Start date (EU): 2022-09-01. Decision date: 2024-11-05. Results received: No. Last updated: 2024-11-05.

Condition(s): The trial is about comparing the efficacy of Plenvu with Picoprep. Both are bowel cleansing agents prior to colonoscopy. The patients to be examined are all referred to exclude colorectal cancer disease. The cleansing process is not directly related to treatment of these patients but have an effect on the visualisation of the mucosa of the bowel and thus the quality of the colonoscopy.
Product: Plenvu, Picoprep, pulver til oral opløsning

Primary endpoint: Efficacy of plenvu is not inferior to picoprep
Endpoint(s): Tolerability of plenvu is not inferior to picoprep

Source: https://euclinicaltrials.eu/ctis-public/view/2024-518544-21-00